EU clinical trial 2024-516554-22-00: A phase II trial of neoadjuvant REGorafenib in combination with nIvolumab and short-course radiotherapy iN intermediate-risk, stage II-III rectAl cancer
Protocol code: IJB-REGINA-2020
Sponsor: Institut Jules Bordet (Hospital/Clinic/Other health care facility). Phase: Therapeutic exploratory (Phase II). Countries: Belgium (ongoing, recruitment ended).
Therapeutic area(s): Diseases [C] - Neoplasms [C04]
Gender: Female, Male. Age: 18-64 years. Enrolment: 90.
Status: Ongoing, recruitment ended. Start date (EU): 2021-03-29. Decision date: 2024-08-29. Results received: No. Last updated: 2026-05-19.

Condition(s): Locally-advanced stage II-III rectal cancer
Product: OPDIVO 10 mg/mL concentrate for solution for infusion., Regorafenib_IJB

Primary endpoint: Complete response (CR) rate (including either pathological [pCR] or clinical complete response [cCR]) in subjects with pMMR/MSS tumours
Endpoint(s): CR rate in the mMiITT population (including both pMMR/MSS and dMMR/MSI-H tumours), Toxicity, Compliance to treatment, R0 resection rate, Pathological tumour regression grade (pTRG), Local recurrence rate, Distant recurrence rate, Event-free survival (EFS), Overall survival (OS), CD3 and CD8 T-cells infiltrate increase in post-treatment tumour tissue samples

Source: https://euclinicaltrials.eu/ctis-public/view/2024-516554-22-00